EU clinical trial 2023-509569-19-00: A multicenter, randomized, open-label, blinded endpoint evaluation, phase 3 study comparing the effect of abelacimab relative to apixaban on venous thromboembolism (VTE) recurrence and bleeding in patients with cancer associated VTE (ASTER)
Protocol code: ANT-007
Sponsor: Anthos Therapeutics Inc. (Pharmaceutical company). Phase: Phase II and Phase III (Integrated). Countries: Latvia (ended), Ireland (ended), Italy (ended), Czechia (ended), Spain (ended), Germany (ended), Sweden (ended), France (ended), Norway (ended), Hungary (ended), Austria (ended), Netherlands (ended).
Therapeutic area(s): Diseases [C] - Cardiovascular Diseases [C14]
Gender: Female, Male. Age: 18-64 years, 65+ years. Enrolment: 935.
Status: Ended. Start date (EU): 2022-08-10. End date (EU): 2026-02-02. End date: 2026-02-05. Decision date: 2024-07-26. Results received: No. Last updated: 2026-03-04.
Decision dates by country: AT: 2024-08-05, HU: 2024-07-31, IT: 2024-08-05, IE: 2024-07-29, DE: 2024-08-02, ES: 2024-07-31, CZ: 2024-08-01, SE: 2024-07-29, NL: 2024-07-26, FR: 2024-07-31, NO: 2024-07-30, LV: 2024-07-29

Condition(s): venous thromboembolism (VTE)
Product: Abelacimab 150 mg/ml solution for infusion, Eliquis 5 mg film-coated tablets

Primary endpoint: Time to first event of centrally adjudicated VTE recurrence through 6 months

Source: https://euclinicaltrials.eu/ctis-public/view/2023-509569-19-00